EU clinical trial 2024-510893-25-00: Corticodependent or corticoresistant brain radionecrosis after radiotherapy for brain metastases: a multicentre randomized, controlled double-blind phase III study, comparing bevacizumab versus placebo (BRADI)
Protocol code: BRADI ICO-2023-15
Sponsor: Institut De Cancerologie De L Ouest (Hospital/Clinic/Other health care facility). Phase: Therapeutic confirmatory (Phase III). Countries: France (ongoing, recruiting).
Therapeutic area(s): Diseases [C] - Neoplasms [C04]
Gender: Female, Male. Age: 18-64 years, 65+ years. Enrolment: 84.
Status: Ongoing, recruiting. Start date (EU): 2025-04-29. Decision date: 2024-06-03. Results received: No. Last updated: 2026-07-06.

Condition(s): Brain metastases of cancer > brain radionecrosis
Product: Avastin 25 mg/ml concentrate for solution for infusion., Sodium Chloride Fresenius Kabi Italia 0.9 % Solution for infusion , Prednisolone 10mg Tablets

Primary endpoint: - Corticosteroids dose at Cycle 1 Day 1 (C1D1) and at 3 months (90 days, End of treatment (EOT) visit) - NANO (Neurological Assessment in Neuro-Oncology) score (60) at C1D1 and at 3 months (90 days -EOT visit) The NANO scale evaluates 8 major domains of neurologic function that are most relevant to patients with supratentorial, infratentorial, and brainstem tumors
Endpoint(s): a) Safety assessed using the National Cancer Institute Common Toxicity Criteria for Adverse Events (NCI-CTCAE), version 5.0 for up to 90 days following C1D1, b) Quality of life is measured with EORTC QLQ-C30 and BN20 (59) ; assessed at C1D1, C2D1, C3D1, C4D1 and EOT visit, c) Success assessed using: - Corticosteroid’s dose: at C1D1 and at 3 months (90 days) - NANO score: at C1D1, C2D1, C3D1, C4D1 and EOT visit - EORTC QLQC-30 and BN20 scores: at C1D1, C2D1, C3D1, C4D1 and EOT visit, d) Clinical changes assessed using: - Patient Global Impression of Change (PGIC) questionnaire (from 1 to 7) and Scale (from 0 to 10): at C4D1 and EOT visit - NANO score: at C1D1, C2D1, C3D1, C4D1 and EOT visit, e) volume on brain MRI T1 post-gadolinium and T2-weighted FLAIR: at EOT visit, f) Duration of response assessed using: - NANO scale: every 3 months until 2 years - dose of corticosteroids: every 3 months until 2 years, g) Corticosteroids dose at 3 months and vital status up to 3 months, h) Correlative biomarkers (ceramide, VEGF, angiopoietin, TGF-alpha) and nuclear medicine images

Source: https://euclinicaltrials.eu/ctis-public/view/2024-510893-25-00